EU clinical trial 2024-511613-38-01: Cognitive brain circuits and the spread of tau in vivo in humans.
Sponsor: UZ Leuven (Hospital/Clinic/Other health care facility). Phase: Phase III and phase IV (Integrated). Countries: Belgium (ongoing, recruiting).
Therapeutic area(s): Diseases [C] - Nervous System Diseases [C10]
Gender: Female, Male. Age: 18-64 years, 65+ years. Enrolment: 160.
Status: Ongoing, recruiting. Start date (EU): 2018-05-18. Decision date: 2024-08-27. Results received: No. Last updated: 2024-08-27.

Condition(s): Alzheimer disease in a preclinical and prodromal stage
Product: [18F]MK-6240

Primary endpoint: Effect of tau aggregates on activity amplitude in the perisylvian network 2. Effect of tau aggregates on functional connectivity measures
Endpoint(s): Effect of tau aggregates on EEG based measures of functional connectivity

Source: https://euclinicaltrials.eu/ctis-public/view/2024-511613-38-01